EU clinical trial 2024-516464-28-00: Prospective diagnostic performance of PET/CT using the novel fibroblast imaging tracer 18F-AlF-FAPI-74 versus standard of care 18F-FDG in inflammatory disorders.
Sponsor: UZ Leuven (Hospital/Clinic/Other health care facility). Phase: Phase II and Phase III (Integrated). Countries: Belgium (ongoing, recruiting).
Therapeutic area(s): Diseases [C] - Musculoskeletal Diseases [C05]; Diseases [C] - Immune System Diseases [C20]
Gender: Female, Male. Age: 18-64 years, 65+ years. Enrolment: 192.
Status: Ongoing, recruiting. Start date (EU): 2025-08-27. Decision date: 2025-05-08. Results received: No. Last updated: 2026-07-13.

Condition(s): Fever of unknown origin/Inflammation of unknown origin IgG4-related disease; Axial Spondyloartrhitis

Primary endpoint: 1. FUO/IUO: sensitivity for evaluating the origin of fever and/or inflammation. 2. sensitivity for diagnosing IgG4-RD in patients with suspected IgG4-RD and assessment of disease extent in patients with confirmed IgG4-RD using the organ detection ratio. 3. AxSpA: sensitivity and specificity in differentiating inflammatory back pain from mechanical back pain. 4. NMD: Diagnostic accuracy in differentiating inflammatory neuromuscular disorders from other neuromuscular discorders and healtyh contro

Source: https://euclinicaltrials.eu/ctis-public/view/2024-516464-28-00